EU clinical trial 2024-519728-26-00: Frozen shoulder – the role of physiotherapy
Sponsor: Oslo University Hospital HF (Hospital/Clinic/Other health care facility). Phase: Therapeutic use (Phase IV). Countries: Norway (ongoing, recruiting).
Therapeutic area(s): Diseases [C] - Musculoskeletal Diseases [C05]
Gender: Female, Male. Age: 18-64 years, 65+ years. Enrolment: 180.
Status: Ongoing, recruiting. Start date (EU): 2026-01-12. Decision date: 2025-06-04. Results received: No. Last updated: 2025-12-04.

Condition(s): Frozen shoulder
Product: TRIAMCINOLONE, LIDOCAINE

Primary endpoint: Shoulder Pain and Disability Index
Endpoint(s): Pain intensity rest and activity, Quick-DASH, EQ-5D-5L, Hopkins Symptom Checklist-10, Tampa Scale of Kinesiophobia, iMTA Medical Consumption Questionnaire, iMTA Productivity Cost Questionnaire, Patient Accepted Symptom State, Global Rating of Change scale

Source: https://euclinicaltrials.eu/ctis-public/view/2024-519728-26-00